EU clinical trial 2023-509287-26-00: Liposomal iRInotecan, Carboplatin or oXaliplatin in the first line treatment of esophagogastric cancer: a randomized phase 2 study (LyRICX)
Sponsor: Amsterdam UMC (Hospital/Clinic/Other health care facility). Phase: Therapeutic exploratory (Phase II). Countries: Netherlands (ongoing, recruitment ended).
Therapeutic area(s): Diseases [C] - Neoplasms [C04]
Gender: Female, Male. Age: 18-64 years, 65+ years. Enrolment: 322.
Status: Ongoing, recruitment ended. Start date (EU): 2019-07-01. Decision date: 2024-10-28. Results received: No. Last updated: 2025-11-04.

Condition(s): previously untreated metastatic or locally advanced esophagogastric cancer
Product: Fluorouracil 50mg/ml Injection., Carboplatin 10 mg/ml Intravenous Infusion, OPDIVO 10 mg/mL concentrate for solution for infusion., Onivyde pegylated liposomal 4.3 mg/ml concentrate for dispersion for infusion, Xeloda 500 mg film-coated tablets, Oxaliplatin 5mg/ml concentrate for Solution for Infusion

Primary endpoint: Progression free survival 1 and neurotoxicity. Progression free survival 1 is defined as the time from start of study treatment, until the first moment of disease progression.
Endpoint(s): Progression free survival 2: in case of reintroduction of study treatment after progression, progression free survival 2 is the time until progression occurs after this reintroduction. In case of start of second line treatment after progression, the time from start until discontinuation of second line is taken as progression free survival 2., Quality of life, Overall survival, Response rate according to RECIST 1.1, Adverse events according to NCI CTCAE version 5.0., Percentage of patients proceeding to subsequent lines of treatment after progression and describe the types of subsequent treatments, Reasons for forgoing subsequent treatment after progression, To compare the primary and above mentioned secondary objectives for patients treated with and without nivolumab

Source: https://euclinicaltrials.eu/ctis-public/view/2023-509287-26-00